EU clinical trial 2023-505155-47-00: Pyridoxine in primary sclerosing cholangitis
Protocol code: 1.1
Sponsor: Oslo University Hospital HF (Hospital/Clinic/Other health care facility). Phase: Therapeutic exploratory (Phase II). Countries: Norway (ongoing, recruitment ended).
Therapeutic area(s): Diseases [C] - Digestive System Diseases [C06]
Gender: Female, Male. Age: 18-64 years, 65+ years. Enrolment: 26.
Status: Ongoing, recruitment ended. Start date (EU): 2024-06-19. Decision date: 2023-11-16. Results received: No. Last updated: 2023-11-16.

Condition(s): Primary sclerosing cholangitis
Product: Encapsulated tablets of inactive ingredients, PYRIDOXINE HYDROCHLORIDE, PYRIDOXINE HYDROCHLORIDE

Primary endpoint: Difference in mean change of alkaline phosphatase (ALP) between the 12-week pyridoxine phase and the 12-week placebo phase
Endpoint(s): Difference in mean change in PLP levels and HKratio between the 12-week pyridoxine phase and the 12-week placebo phase, Changes in ALAT, ASAT, GGT, total bilirubin between the 12-week pyridoxine phase and the 12-week placebo phase, Difference in mean change in the Enhanced Liver Fibrosis test (ELF) between the 12-week pyridoxine phase and the 12-week placebo phase, Difference in mean change in interleukin-8 and neopterin between the 12-week pyridoxine phase and the 12-week placebo phase, Difference in mean change in PSC-specific revised Mayo risk score; the Amsterdam-Oxford model (AOM); PREsTo; between the 12-week pyridoxine phase and the 12-week placebo phase, Difference in mean change in SF-36 Physical summary scale and Mental summary scale between the 12-week pyridoxine phase and the 12-week placebo phase, Difference in mean change of fatigue, evaluated by the Fatigue Impact Scale (FIS) fatigue and a fatigue numerical rating scale (NRS) between the 12-week pyridoxine phase and the 12-week, Difference in mean change of a pruritus numerical rating scale (NRS) between the 12-week pyridoxine phase and the 12-week placebo phase, Number of adverse events and serious adverse advents during the study period, Change in PLP levels and HKratio after open label treatment 12 weeks of 40 mg pyridoxine and 12 weeks of 1.6 mg pyridoxine, Change in alkaline phosphatase levels after open label treatment 12 weeks of 40 mg pyridoxine and 12 weeks of 1.6 mg pyridoxine

Source: https://euclinicaltrials.eu/ctis-public/view/2023-505155-47-00